EU clinical trial 2023-508411-23-00: PREDIX HER2 - Neoadjuvant response-guided treatment of HER2 positive breast cancer. Part of a platform of translational phase II trials based on molecular subtypes
Sponsor: Karolinska University Hospital (Hospital/Clinic/Other health care facility). Phase: Therapeutic exploratory (Phase II). Countries: Sweden (ongoing, recruitment ended).
Therapeutic area(s): Diseases [C] - Neoplasms [C04]
Gender: Female, Male. Age: 18-64 years, 65+ years. Enrolment: 200.
Status: Ongoing, recruitment ended. Start date (EU): 2014-11-12. Decision date: 2023-10-02. Results received: No. Last updated: 2025-11-17.

Condition(s): Primary breast cancer
Product: Herceptin 600 mg solution for injection in vial, Kadcyla 100 mg powder for concentrate for solution for infusion., Docetaxel Accord 20 mg/1 ml concentrate for solution for infusion, Perjeta 420 mg concentrate for solution for infusion

Primary endpoint: Pathological objective response to primary medical treatment
Endpoint(s): Clinical/radiological objective response during neoadjuvant treatment, Morphological, functional and biological characteristics of tumors exposed to cytotoxic and targeted treatment of early breast cancer, Event-free survival (EFS), invasive disease-free survival (IDFS), distant disease-free survival (DDFS), breast cancer-specific survival (BCSS) and overall survival (OS), Safety, Quality of life, Frequency of breast-conserving surgery

Source: https://euclinicaltrials.eu/ctis-public/view/2023-508411-23-00